EU clinical trial 2025-523930-14-00: Impact of treatment with TransCon PTH on Quality of Life, cognitive function, brain structure, and cerebral capillary bloodflow in patients with hypoparathyroidism
Sponsor: Region Midtjylland (Hospital/Clinic/Other health care facility). Phase: Therapeutic use (Phase IV). Countries: Denmark (authorised, recruitment pending).
Therapeutic area(s): Diseases [C] - Hormonal diseases [C19]
Gender: Female, Male. Age: 18-64 years, 65+ years. Enrolment: 40.
Status: Authorised, recruitment pending. Decision date: 2026-04-20. Results received: No. Last updated: 2026-04-20.

Condition(s): Hypoparathyroidism
Product: Alfacalcidol Stada 1 micrograme capsule moi, Yorvipath 168 micrograms/0.56 mL solution for injection in pre‑filled pen

Primary endpoint: Difference in microvascular hemodynamic between PTH- and conventionally treated patients with chronic HypoPT
Endpoint(s): Correlation between cognitive impairment measured by neuropsychological assessment and capillary transit time heterogeneity, cortical blood volume and hemodynamic parameters., Status of cognitive function in PTH treated compared to conventional treated controls, Difference in groups in size of structures in the brain.

Source: https://euclinicaltrials.eu/ctis-public/view/2025-523930-14-00